EU clinical trial 2024-511790-30-00: APICALE - Cervical facet injection of corticosteroids for the management of cervicobrachialgia : protocol for a randomized pilot study
Sponsor: Assistance Publique Hopitaux De Paris (Hospital/Clinic/Other health care facility). Phase: Therapeutic confirmatory (Phase III). Countries: France (authorised, recruitment pending).
Therapeutic area(s): Diseases [C] - Nervous System Diseases [C10]
Gender: Female, Male. Age: 18-64 years, 65+ years. Enrolment: 70.
Status: Authorised, recruitment pending. Decision date: 2026-03-06. Results received: No. Last updated: 2026-03-06.

Condition(s): Cervicobrachial Neuralgia
Product: NaCl 0.9%, DEXAMETHASONE

Primary endpoint: Radicular pain (RP) assessed using a simple self-administered numeric rating scale, ranging from 0 (no pain) to 100 (maximum pain), over the 48 hours preceding the 1-month visit assessment compared to the baseline.
Endpoint(s): Cervical pain (numeric rating scale, self-administered, ranging from 0 to 100) over the 48 hours preceding Day 15, 1 month, 2 month and 3 month,, The Neck Disability Index (NDI) score (self-administered functional scale, ranging from 0 to 50) at Month 1 and Month 3, and professional status (self-reported: employed, on sick leave, disabled, unemployed, inactive, retired) at Month 1 and Month 3,, The self-administered EQ-5D-5L quality of life scale at Month 1 and Month 3,, Radicular pain (numeric rating scale, self-administered, ranging from 0 to 100) over the 48 hours preceding Day 15, month 2, and month 3,, The occurrence of adverse events (AEs) and serious adverse events (SAEs) at each visit. Surgical intervention will be considered as a SAE, The use of analgesics (levels 1, 2, or 3) since the last visit, using a self-administered 4-level scale (never, several times a month, several times a week, daily) at Day 15, 1, 2 and 3 months post-injection.

Source: https://euclinicaltrials.eu/ctis-public/view/2024-511790-30-00